EU clinical trial 2023-503186-35-00: Open-Label Pilot Trial to Evaluate the Effects of Ilofotase Alfa on Biomarkers in Adult Patients with Hypophosphatasia
Protocol code: AP-recAP-HPP-01-01
Sponsor: AM-Pharma B.V. (Pharmaceutical company). Phase: Human Pharmacology (Phase I)- Other. Countries: Germany (ended).
Therapeutic area(s): Diseases [C] - Congenital, Hereditary, and Neonatal Diseases and Abnormalities [C16]
Gender: Female, Male. Age: 18-64 years, 65+ years. Enrolment: 12.
Status: Ended. Start date (EU): 2023-05-03. End date (EU): 2023-07-12. Decision date: 2023-05-02. Results received: Yes. Last updated: 2023-05-09.

Condition(s): Hypophosphatasia
Product: Ilofotase alfa

Primary endpoint: The effect of a low or high dose of ilofotase alfa on the biochemical profile in adult HPP patients.

Source: https://euclinicaltrials.eu/ctis-public/view/2023-503186-35-00